EU clinical trial 2023-509433-40-00: Enhancing social skills in schizophrenia spectrum disorders – two-arm, double-blind, randomized clinical trial investigating oxytocin vs. placebo as an add-on to an individualized psychosocial treatment (OXY-APS)
Protocol code: OXY-APS
Sponsor: Zentralinstitut Fuer Seelische Gesundheit (Hospital/Clinic/Other health care facility). Phase: Therapeutic exploratory (Phase II). Countries: Germany (temporarily halted).
Therapeutic area(s): Psychiatry and Psychology [F] - Mental Disorders [F03]
Gender: Female, Male. Age: 18-64 years. Enrolment: 98.
Status: Temporarily halted. Start date (EU): 2024-08-29. Decision date: 2024-05-16. Results received: No. Last updated: 2026-08-07.
Decision dates by country: DE: 2024-05-17

Condition(s): schizophrenia or other primary psychotic disorders (SSD)
Product: OXYTOCIN, Oxytocin Placebo

Primary endpoint: Change of Personal and Social Performance Scale (PSP) after 12 weeks (V1-V4)
Endpoint(s): Improvement in psychopathology from baseline (PANSS, BPRS, CGI-SCH), social and occupational functioning (GAF) and quality of life (WHODAS 2.0, The Oxford Positive Self Scale )., Changes from baseline in the Calgary Depression Scale for Schizophrenia (CDSS)., Changes from baseline in Neurocognition (B-CATS)., all-cause discontinuation, EMA (ecological momentary assessment) and passive sensing, Drug Attitude Inventory (DAI) and self-reported treatment adherence., cumulative dose of concomitant or rescue medication., Genetic alterations in the oxytocin receptor gene, Changes of biomarkers: alteration in brain networks, DNAmethylation, Oxytocin in blood and saliva., Measurement of real-life social contacts, Measurement of physical activity

Source: https://euclinicaltrials.eu/ctis-public/view/2023-509433-40-00